EU clinical trial 2025-523263-37-00: ROSETTA Gastric-204: A Blinded, Randomized, Phase 2/3 Study of Pumitamig in Combination with Chemotherapy Versus Nivolumab in Combination with Chemotherapy in Participants with Previously Untreated Advanced or Metastatic Gastric, Gastroesophageal Junction, or Esophageal Adenocarcinoma
Protocol code: CA2660004
Sponsor: Bristol-Myers Squibb Services Unlimited Company (Pharmaceutical company). Phase: Phase II and Phase III (Integrated). Countries: Germany (ongoing, recruiting), Spain (ongoing, recruiting), Poland (authorised, recruiting), France (authorised, recruitment pending), Italy (ongoing, recruiting), Romania (ongoing, recruiting).
Therapeutic area(s): Diseases [C] - Neoplasms [C04]
Gender: Female, Male. Age: 18-64 years, 65+ years. Enrolment: 184.
Start date (EU): 2026-04-08. Decision date: 2026-03-10. Results received: No. Last updated: 2026-08-07.
Decision dates by country: ES: 2026-03-12, PL: 2026-03-23, RO: 2026-04-17, IT: 2026-03-24, DE: 2026-03-10, FR: 2026-03-25

Condition(s): Previously Untreated Advanced or Metastatic Gastric, Gastroesophageal Junction, or Esophageal Adenocarcinoma
Product: OPDIVO 10 mg/mL concentrate for solution for infusion., BNT327 50 mg ml, CALCIUM FOLINATE, OXALIPLATIN, FLUOROURACIL, CAPECITABINE, CAPECITABINE, BNT327 20 mg ml

Primary endpoint: (Phase 2): ORR, to compare how two different doses of the study drug affect tumor growth to help select the better dose., (Phase 3): PFS (progression-free survival) by BICR (Blinded Independent Central Review) The ability of Pumitamig to work better than current standard treatment by assessing how long it takes before the cancer starts growing again by radiographic imaging techniques (like CT scans)., (Phase 3): OS (Overall Survival) This study will assess if people live longer when they take Pumitamig compared to other standard treatment, nivolumab.
Endpoint(s): (Phase 2): PFS (progression-free survival) by RECIST v1.1 per investigator assessment, defined as the time between the randomization date and the date of first documented tumor progression or death from any cause (whichever occurs first), (Phase 3): Duration of response (Partial Response or Complete Response) by RECIST v1.1 per investigator assessment, defined as the time between the date of the first documentation of objective tumor response (Complete Response or Partial Response) and the date of disease progression or to death from any cause (whichever occurs first), (Phase 2): Time to response (Complete Response or Partial Response) by RECIST v1.1 per investigator assessment, defined as the time between randomization to the date of the first documentation of objective tumor response, (Phase 2): Disease control (Best overall response of confirmed Complete Response, confirmed Partial Response, or Stable Disease) by RECIST v1.1 per investigator assessment, (Phase 2): Recommended dose of pumitamig for Phase 3, (Phase 3): Objective Response by RECIST v1.1 per BICR, (Phase 3): Duration of response by RECIST v1.1 per BICR

Source: https://euclinicaltrials.eu/ctis-public/view/2025-523263-37-00